EU clinical trial 2023-510499-30-00: A Double-Blinded, Placebo-Controlled Exploratory Study to Investigate the Efficacy and Safety of Flexible dosing of Oral Lidocaine (ORE-001) to Reduce Abdominal Discomfort and Prevent Early Satiety in Anorexia Nervosa Patients
Protocol code: OREPhIIAnorexia
Sponsor: Orexa B.V. (Pharmaceutical company). Phase: Therapeutic exploratory (Phase II). Countries: Italy (authorised, recruitment pending).
Therapeutic area(s): Diseases [C] - Nutritional and Metabolic Diseases [C18]
Gender: Female. Age: 18-64 years. Enrolment: 18.
Status: Authorised, recruitment pending. Decision date: 2025-02-12. Results received: No. Last updated: 2025-02-12.

Condition(s): Anorexia nervosa
Product: Composition [mg/tablet]: Microcrystalline cellulose 243.9, Sodium bicarbonate 15.9, Hydroxypropyl methylcellulose 47.7, Sodium croscarmellose 4.5, Silicon dioxide 3.2, Magnesium stearate plant 3.2, Eudragit E PO Ready Mix 12.7

Primary endpoint: Difference between ORE-001 and placebo in change from baseline in VAS scores for satiety sensations on Day 28
Endpoint(s): Difference between ORE-001 and placebo in change from baseline in late fullness (prior to lunch) in VAS scores for satiety sensations on Day 28, Difference between ORE-001 and placebo in change from baseline in VAS score for GI symptoms on Day 28, Difference between ORE-001 and placebo in change from baseline in body weight at Day 28., Daily change from baseline in the weight of food and calorie intake per meal., Difference between ORE-001 and placebo in change from baseline in total IEDOQL score on Day 28., Difference between ORE-001 and placebo in change from baseline in MOS sleep scale on Day 28., Treatment-Emergent Adverse Events (AE) and serious adverse events (SAE) up to end of study, Change from Baseline in the levels of biomarkers (Leptin, ghrelin, oxytocin, peptide Y (PYY), and brain-derived neurotropic factor (BDNF)) associated with satiety at End of Treatment

Source: https://euclinicaltrials.eu/ctis-public/view/2023-510499-30-00